EU clinical trial 2025-522070-36-00: A multi-center, open-label, single-arm study to evaluate the efficacy and safety of oral rilzabrutinib in adults with immune thrombocytopenia (ITP) who failed first-line treatment
Protocol code: LPS18573
Sponsor: Sanofi-Aventis Recherche & Developpement (Pharmaceutical company). Phase: Therapeutic confirmatory (Phase III). Countries: France (ongoing, recruiting), Spain (ongoing, recruiting), Italy (ongoing, recruiting), Germany (authorised, recruitment pending), Czechia (authorised, recruitment pending), Poland (ongoing, recruiting), Hungary (authorised, recruitment pending), Austria (authorised, recruitment pending).
Therapeutic area(s): Diseases [C] - Immune System Diseases [C20]
Gender: Female, Male. Age: 18-64 years, 65+ years. Enrolment: 41.
Start date (EU): 2025-12-15. Decision date: 2025-10-07. Results received: No. Last updated: 2026-08-03.
Decision dates by country: HU: 2025-10-10, PL: 2025-10-10, ES: 2025-10-09, IT: 2025-10-07, DE: 2025-10-08, CZ: 2025-10-08, AT: 2025-10-13, FR: 2025-10-10

Condition(s): immune thrombocytopenia (ITP)
Product: Rilzabrutinib

Primary endpoint: The main study endpoint is to check the durable platelet response ie, to see how many participants can keep their platelet count at a safe level., The durable platelet response is the percentage of participants who can maintain a platelet count of at least 50,000 /μL (or between 30,000/μL and 50,000/μL and at least double their starting count) for at least half of their scheduled platelet checks every 2 weeks and for at least 4 valid visits in the last 12 weeks of the study, without needing rescue treatment.
Endpoint(s): 1. Overall platelet response: The percentage of participants who can achieve 2 platelet counts, at least 5 days apart, of at least 50,000/μL (or between 30,000/μL and 50,000/μL but at least double their starting count) without needing rescue treatment in the 4 weeks before the first high platelet count., 2. Duration of platelet response: The total number and proportion of weeks where participants maintain platelet counts of at least 50,000/μL (or between 30,000/μL and 50,000/μL but at least double their starting count) without needing rescue treatment in the 4 weeks before the high platelet count in participants who achieve a response., 3. Bleeding: The change in immune thrombocytopenia bleeding scale score from the start of the study to the end of Week 28., 4. Corticosteroid-sparing effect: The percentage of participants who can stop or reduce their corticosteroid dose by at least 50% or to less than 5 mg/day (prednisone equivalent) from the start of the study by the end of Week 28

Source: https://euclinicaltrials.eu/ctis-public/view/2025-522070-36-00